EU clinical trial 2025-524249-29-00: A placebo-controlled comparability study to compare two presentations of cagrilintide for weight management in participants with overweight or obesity
Protocol code: NN9833-8550
Sponsor: Novo Nordisk A/S (Pharmaceutical company). Phase: Therapeutic confirmatory (Phase III). Countries: Sweden (ongoing, recruiting), Greece (ongoing, recruiting), Hungary (ongoing, recruiting), Portugal (ongoing, recruiting).
Therapeutic area(s): Diseases [C] - Nutritional and Metabolic Diseases [C18]
Gender: Female, Male. Age: 18-64 years, 65+ years. Enrolment: 171.
Status: Ongoing, recruiting. Start date (EU): 2026-07-22. Decision date: 2026-07-20. Results received: No. Last updated: 2026-07-21.
Decision dates by country: GR: 2026-07-21, HU: 2026-07-21, PT: 2026-07-21, SE: 2026-07-20

Condition(s): Participants with overweight or obesity
Product: cagrilintide D 10137, Placebo, cagrilintide D 10138, cagrilintide, cagrilintide, cagrilintide D 10135, cagrilintide, cagrilintide, cagrilintide D 10136, Placebo

Primary endpoint: Relative change in body weight from baseline (week 0) to end of treatment (week 26)
Endpoint(s): Number of treatment emergent adverse events (TEAEs) from baseline (week 0) to end of study (week 33), Number of treatment emergent serious adverse events (TESAEs) from baseline (week 0) to end of study (week 33)

Source: https://euclinicaltrials.eu/ctis-public/view/2025-524249-29-00